EU clinical trial 2023-508681-15-00: A Randomized, Double-blind, Placebo-Controlled, Multicenter Study to Evaluate the Safety, Tolerability, and Efficacy of XEN1101 as Adjunctive Therapy in Focal-Onset Epilepsy, With an Open-label Extension
Protocol code: XPF-008-201
Sponsor: Xenon Pharmaceuticals Inc. (Pharmaceutical company). Phase: Therapeutic exploratory (Phase II). Countries: Spain (ongoing, recruitment ended), Germany (ongoing, recruitment ended), Italy (ongoing, recruitment ended).
Therapeutic area(s): Diseases [C] - Nervous System Diseases [C10]
Gender: Female, Male. Age: 18-64 years, 65+ years. Enrolment: 182.
Status: Ongoing, recruitment ended. Start date (EU): 2019-05-28. Decision date: 2024-08-22. Results received: No. Last updated: 2026-01-16.
Decision dates by country: DE: 2024-09-02, IT: 2024-09-16, ES: 2024-08-22

Condition(s): Adult focal (partial onset) epilepsy
Product: XPF-010, XPF-008, XEN1101 placebo

Primary endpoint: 1. Median percent change in monthly (28 days) focal seizure frequency from baseline to DBP for XEN1101 versus placebo., 2. Severity and frequency of associated AEs/SAEs, clinically significant changes in clinical laboratory findings and/or 12-lead ECG, increase in suicide risk as assessed by the C-SSRS Scale including increase in suicidal thoughts or an attempt, clinically significant changes in vital signs including blood pressure, pulse, or weight, and clinically significant changes in urological symptoms including retention as measured by the AUA-SI in the DBP.
Endpoint(s): 3. Responders are defined as subjects experiencing ≥50% reduction in monthly (28 days) focal seizure frequency from baseline compared to DBP., 4. Percent change from baseline in weekly focal seizure frequency for each week in the DBP., 5. CGI-C and PGI-C scores during the DBP.

Source: https://euclinicaltrials.eu/ctis-public/view/2023-508681-15-00